EU clinical trial 2023-504033-44-00: Botulinumtoxin A as a treatment for myalgia and myofacial pain in patient with temporomandibulardisorders – a quality study associated to a new treatment routine.
Protocol code: BTXclinicaltrialEA
Sponsor: Region Stockholm Folktandvarden (Hospital/Clinic/Other health care facility). Phase: Therapeutic confirmatory (Phase III). Countries: Sweden (ongoing, recruiting).
Therapeutic area(s): Diseases [C] - Stomatognathic Diseases [C07]; Diseases [C] - Musculoskeletal Diseases [C05]
Gender: Female. Age: 18-64 years. Enrolment: 1.
Status: Ongoing, recruiting. Start date (EU): 2025-05-01. Decision date: 2024-02-05. Results received: No. Last updated: 2024-02-05.

Condition(s): Temporomandibular disorder
Product: CLOSTRIDIUM BOTULINUM NEUROTOXIN TYPE A (150KD), FREE OF COMPLEXING PROTEINS

Primary endpoint: Changes in pain and if the dose matters for pain relief is the primary outcome.
Endpoint(s): Changes in quality of life according to OHIP. Treatment outcome in sub-groups of myogenous TMD. Maximum jaw opening with and without pain between doses and subgroups. The patient´s changes psychosocially, how the jawfunction is affected according to changes in Axis II and changes in PPT.

Source: https://euclinicaltrials.eu/ctis-public/view/2023-504033-44-00